EU clinical trial 2023-504913-65-01: The SEMAFOOT2 Pilot. Effect of semaglutide on healing of foot ulcers in type 2 diabetes patients. A Pilot study.
Protocol code: CODIF-015
Sponsor: Bispebjerg Hospital (Hospital/Clinic/Other health care facility). Phase: Therapeutic exploratory (Phase II). Countries: Denmark (ongoing, recruiting).
Therapeutic area(s): Diseases [C] - Nutritional and Metabolic Diseases [C18]; Diseases [C] - Hormonal diseases [C19]
Gender: Female, Male. Age: 18-64 years, 65+ years. Enrolment: 100.
Status: Ongoing, recruiting. Start date (EU): 2026-04-24. Decision date: 2025-06-15. Results received: No. Last updated: 2025-09-29.

Condition(s): Type 2 diabetes, Diabetic foot ulcer
Product: Ozempic 1 mg solution for injection in pre-filled pen, Ozempic 0.5 mg solution for injection in pre-filled pen, Ozempic 0.25 mg solution for injection in pre-filled pen, Blinded to the test product

Primary endpoint: Proportion of index ulcers completely healed after 20 weeks of intervention
Endpoint(s): Change in ulcer area from time of randomization until after 20 weeks of intervention

Source: https://euclinicaltrials.eu/ctis-public/view/2023-504913-65-01